EU clinical trial 2024-517768-52-00: DARIdorexant efficacy on the COGnitive performance in patients with chronic insomnia disorder. DARI-COG Study
Sponsor: Universita' Degli Studi Di Roma Tor Vergata (Educational Institution). Phase: Therapeutic use (Phase IV). Countries: Italy (ongoing, recruiting).
Therapeutic area(s): Diseases [C] - Nervous System Diseases [C10]
Gender: Female, Male. Age: 18-64 years. Enrolment: 25.
Status: Ongoing, recruiting. Start date (EU): 2025-07-11. Decision date: 2025-03-04. Results received: No. Last updated: 2025-05-04.

Condition(s): Insonnia cronica
Product: QUVIVIQ 50 mg film-coated tablets

Primary endpoint: 1. Change in insomnia severity index (ISI) total score at 3- and 6-month follow-up visits; 2. Change in subjective total sleep time (sTST) measured by sleep diary in the 7 days before the visit planned at 3- and 6-month follow-up;
Endpoint(s): Change in cogn perf (attention and memory) measured by neuropsychological tests at the 3and 6monthFUvisits;Change in PSQI total and sub-items scores at 3and 6monthFUvisits;Change in ESS scores at 3and 6monthFUvisits;Change in MEQ scores at 3and 6monthFUvisits;Change in Beck Depression Inventory-II total score at 3and 6monthFUvisits;Change in the mental and physical component of the SF-12 at 3and 6monthFUvisits.

Source: https://euclinicaltrials.eu/ctis-public/view/2024-517768-52-00